EU clinical trial 2024-513727-16-00: PROPANE: An open label phase 2 study on propranolol and pembrolizumab in advanced Angiosarcoma and Undifferentiated Pleomorphic Sarcoma – a Scandinavian Sarcoma Group collaboration
Protocol code: SA2115
Sponsor: Region Hovedstaden (Hospital/Clinic/Other health care facility). Phase: Therapeutic exploratory (Phase II). Countries: Denmark (ongoing, recruiting), Norway (ongoing, recruiting), Sweden (authorised, recruitment pending).
Therapeutic area(s): Diseases [C] - Neoplasms [C04]
Gender: Female, Male. Age: 18-64 years, 65+ years. Enrolment: 100.
Start date (EU): 2022-12-05. Decision date: 2024-05-23. Results received: No. Last updated: 2026-02-09.
Decision dates by country: DK: 2024-05-24, NO: 2024-05-23, SE: 2026-02-09

Condition(s): Advanced Angiosarcoma and Undifferentiated Pleomorphic Sarcoma
Product: PROPRANOLOL HYDROCHLORIDE, KEYTRUDA 25 mg/mL concentrate for solution for infusion, PROPRANOLOL HYDROCHLORIDE

Primary endpoint: Percentage of patients alive with CR, PR and SD according to Response Evaluation Criteria in Solid Tumors (RECIST v1.1) at 3 months
Endpoint(s): Percentage of patients with CR and PR, including duration hereof using RECIST v 1.1, Median PFS and OS, Adverse Events using Common Terminology Criteria for Adverse Events (CTCAE) v5.0, The 30 item European Organization for Research and Treatment of Cancer Quality of Life Questionnaire C30 (EORTC QLQ C30) questionnaire

Source: https://euclinicaltrials.eu/ctis-public/view/2024-513727-16-00